EU clinical trial 2024-516072-15-00: Propofol and Thiopental for intravenous induction in neonates: a dose-finding study (The ProThio Study)
Sponsor: Odense University Hospital (Hospital/Clinic/Other health care facility). Phase: Therapeutic use (Phase IV). Countries: Denmark (ongoing, recruiting).
Therapeutic area(s): Analytical, Diagnostic and Therapeutic Techniques and Equipment [E] - Anesthesia and Analgesia [E03]
Gender: Female, Male. Age: 0-17 years. Enrolment: 160.
Status: Ongoing, recruiting. Start date (EU): 2022-06-16. Decision date: 2024-10-23. Results received: No. Last updated: 2024-10-23.

Condition(s): Neonates (postmenstrual age below 47 weeks) undergoing general anesthesia for any condition
Product: Tiomebumalnatrium SAD, injektionsvæske, opløsning, Propofol B. Braun 1% (10 mg/ml) emulsione iniettabile o per infusione.

Primary endpoint: Loss of eyelash reflex and acceptance of facemask

Source: https://euclinicaltrials.eu/ctis-public/view/2024-516072-15-00